EU clinical trial 2024-515463-55-00: A Phase 3, Multi-Center, Randomized, Double-Blind Study to Evaluate the Efficacy and Safety of Cefepime/Nacubactam or Aztreonam/Nacubactam Compared to Imipenem/Cilastatin in the Treatment of Complicated Urinary Tract Infections or Acute Uncomplicated Pyelonephritis, in Adults (OP0595-5)
Protocol code: OP0595-5
Sponsor: Meiji Seika Pharma Co. Ltd. (Pharmaceutical company). Phase: Therapeutic confirmatory (Phase III). Countries: Latvia (ended), Slovakia (ended), Bulgaria (ended), Estonia (ended), Czechia (ended), Lithuania (ended).
Therapeutic area(s): Diseases [C] - Bacterial Infections and Mycoses [C01]
Gender: Female, Male. Age: 18-64 years, 65+ years. Enrolment: 436.
Status: Ended. Start date (EU): 2023-05-18. End date (EU): 2024-11-26. End date: 2024-11-27. Decision date: 2024-08-28. Results received: Yes. Last updated: 2024-10-03.
Decision dates by country: BG: 2024-09-11, CZ: 2024-08-30, EE: 2024-09-02, LV: 2024-08-28, LT: 2024-10-03, SK: 2024-09-02

Condition(s): Complicated urinary tract infection (cUTI) and acute uncomplicated pyelonephritis (AP)
Product: Nacubactam, Imipenem/Cilastatin Kabi 500 mg/500 mg Pulver zur Herstellung einer Infusionslösung, Cefepim PANPHARMA 2 g Pulver zur Herstellung einer Injektions- bzw. Infusionslösung, AZACTAM 1 g, poudre et solution pour usage parentéral

Primary endpoint: The primary efficacy endpoint is the proportion of patients who achieve composite clinical and microbiological success at TOC (Test of Cure visit) in the Microbiological Modified Intent-to-Treat (m MITT) Population. Composite clinical and microbiological success is defined as the composite clinical outcome of cure and the microbiological outcome of eradication.
Endpoint(s): The secondary efficacy endpoints for cUTI and AP include the following:, The proportion of patients with composite clinical and microbiological success at TOC in the Clinically Evaluable (CE) and Microbiologically Evaluable (ME) Populations;, The proportion of patients with composite clinical and microbiological success at EA, EOT, and FUP in the m MITT Population;, The proportion of patients with a microbiological outcome of eradication at EA, EOT, TOC, and FUP in the m MITT Population and at TOC in the ME Population;, The proportion of patients with a clinical outcome of cure at EA, EOT, TOC, and FUP in the m MITT Population and at TOC in the CE and ME Populations;, The proportion of patients with a clinical outcome of cure at EA, EOT, TOC, and FUP in the m-MITT Population and at TOC in the CE and ME Populations and microbiological outcome of eradication at EA, EOT, TOC, and FUP in the m-MITT Population and at TOC in the ME Population per type of pathogen, type of resistance, and antimicrobial susceptibility; and, The proportion of patients with composite clinical outcome of recurrence and/or microbiological outcome of recurrence at the FUP in the m-MITT, CE, and ME population., The secondary efficacy endpoints for secondary bacteremia include the following:, The proportion of patients with composite clinical and microbiological success of cUTI or AP at TOC in the m-MITT, CE, and ME Populations;, The proportion of patients with a clinical outcome of cure from cUTI or AP at TOC in the m-MITT, CE, and ME Populations;, The proportion of patients with a microbiological outcome of eradication from cUTI or AP at TOC in the m-MITT and ME Populations;, The proportion of patients with a clinical outcome of cure from secondary bacteremia at TOC in the m-MITT, CE, and ME Populations;, The proportion of patients with a microbiological outcome of eradication from secondary bacteremia at TOC in the m-MITT and ME Populations;, The proportion of patients in the m-MITT and ME Populations free from the definition of secondary bacteremia AND a clinical outcome of cure from cUTI or AP AND a microbiological outcome of eradication from cUTI or AP at TOC; and, The proportion of patients who are free from secondary bacteremia at TOC in the m-MITT and ME Populations.

Source: https://euclinicaltrials.eu/ctis-public/view/2024-515463-55-00